EU clinical trial 2023-505121-14-00: A Phase 3 Multicenter, Randomized, Double-blind, Placebo-controlled and Deucravacitinib Active Comparator-controlled Study to Evaluate the Efficacy and Safety of JNJ-77242113 for the Treatment of Participants With Moderate to Severe Plaque Psoriasis
Protocol code: 77242113PSO3002
Sponsor: Janssen - Cilag International (Pharmaceutical company). Phase: Therapeutic confirmatory (Phase III). Countries: Italy (not authorised), Hungary (ongoing, recruitment ended), Poland (ongoing, recruitment ended), Germany (ongoing, recruitment ended), France (not authorised), Spain (ongoing, recruitment ended).
Therapeutic area(s): Diseases [C] - Immune System Diseases [C20]
Gender: Female, Male. Age: 18-64 years, 65+ years. Enrolment: 320.
Start date (EU): 2024-01-18. Decision date: 2024-01-17. Results received: No. Last updated: 2026-07-16.
Decision dates by country: FR: 2024-01-22, IT: 2024-01-22, DE: 2024-05-28, HU: 2024-01-22, PL: 2024-02-07, ES: 2024-05-29

Condition(s): Moderate to Severe Plaque Psoriasis
Product: JNJ-77242113, DEUCRAVACITINIB, Film-Coated Tablet without JNJ-77242113, Film-Coated Tablet without Deucravacitinib

Primary endpoint: IGA score of 0 or 1 and a ≥2-grade improvement from baseline at Week 16., PASI 90 at Week 16.

Source: https://euclinicaltrials.eu/ctis-public/view/2023-505121-14-00